EU clinical trial 2023-503996-38-00: A Phase 1a/1b Study Investigating the Safety, Tolerability, Pharmacokinetics, Pharmacodynamics, and Preliminary Antitumor Activity of the DGKζ Inhibitor BGB-30813, Alone or in Combination With the Anti-PD-1 Monoclonal Antibody Tislelizumab, in Patients With Advanced or Metastatic Solid Tumors
Protocol code: BGB-A317-30813-101
Sponsor: Beigene Ltd. (Pharmaceutical company). Phase: Human Pharmacology (Phase I)- First administration to humans. Countries: Spain (ended).
Therapeutic area(s): Diseases [C] - Neoplasms [C04]
Gender: Female, Male. Age: 18-64 years, 65+ years. Enrolment: 60.
Status: Ended. Start date (EU): 2025-05-21. End date (EU): 2025-07-22. End date: 2025-08-20. Decision date: 2023-09-04. Results received: No. Last updated: 2025-07-21.

Condition(s): Advanced or metastatic solid tumors

Source: https://euclinicaltrials.eu/ctis-public/view/2023-503996-38-00